EU clinical trial 2024-514049-13-02: A phase 2a study on the anti-tumoral effect of cannabis oil (THC 10% / CBD 5%) in patients with untreatable advanced hepatocellular carcinoma - the CanHep study
Sponsor: Universitair Medisch Centrum Groningen (Hospital/Clinic/Other health care facility). Phase: Therapeutic exploratory (Phase II). Countries: Netherlands (ongoing, recruiting).
Therapeutic area(s): Diseases [C] - Neoplasms [C04]
Gender: Female, Male. Age: 18-64 years, 65+ years. Enrolment: 20.
Status: Ongoing, recruiting. Start date (EU): 2024-10-29. Decision date: 2024-10-29. Results received: No. Last updated: 2024-10-29.

Condition(s): Patients with untreatable hepatocellulare carcinoma
Product: CANNABIDIOL, DRONABINOL

Primary endpoint: To study objective response rate (ORR) of cannabis oil (THC10% / CBD5%) in untreatable advanced HCC patients by assessing RECIST31 and mRECIST32 criteria on imaging at 9 months after starting cannabis oil.

Source: https://euclinicaltrials.eu/ctis-public/view/2024-514049-13-02